EU clinical trial 2024-511131-97-00: Senicapoc in patients with Progressive Fibrotic ILD (Interstitial Lung Disease) or IPF (Idiopathic Pulmonary Fibrosis) to prevent progression.
Protocol code: FIBROPOC
Sponsor: Lillebaelt Hospital (Hospital/Clinic/Other health care facility). Phase: Therapeutic exploratory (Phase II). Countries: Estonia (ongoing, recruiting), Denmark (ongoing, recruiting).
Therapeutic area(s): Diseases [C] - Respiratory Tract Diseases [C08]
Gender: Female, Male. Age: 18-64 years, 65+ years. Enrolment: 100.
Status: Ongoing, recruiting. Start date (EU): 2025-08-10. Decision date: 2024-08-30. Results received: No. Last updated: 2026-03-02.
Decision dates by country: DK: 2024-08-30, EE: 2024-09-02

Condition(s): Progressive Fibrotic Interstitial Lung Disease
Product: Senicapoc, PLACEBO

Primary endpoint: Rate of decline of FVC (in mL) over a period of 26 weeks
Endpoint(s): Absolute decline in percent predicted forced vital capacity (%FVC) over 13 and 26 weeks, All-cause mortality., Chance in Vas of dyspnea, All-cause non-elective hospitalizations, Respiratory-related mortality, Acute exacerbations (as evaluated by the investigator), Changes in quality of life, assessed by the EQ-5D, Amount and type of adverse events., Changes in quality of life, assessed by the SGRQ-I and K-BILD total score. (Danish and UK sites only)

Source: https://euclinicaltrials.eu/ctis-public/view/2024-511131-97-00